EU clinical trial 2024-516131-28-00: Phase IIa Clinical Trial: Feasibility Study on Non-Invasive Simultaneous Hyperpolarized [1-13C]Pyruvate Magnetic Resonance Spectroscopy and 18F-FDG PET (hyperPET) for Metabolic Imaging in Patients with Cancer
Sponsor: Rigshospitalet (Hospital/Clinic/Other health care facility). Phase: Therapeutic exploratory (Phase II). Countries: Denmark (ongoing, recruiting).
Therapeutic area(s): Analytical, Diagnostic and Therapeutic Techniques and Equipment [E] - Investigative Techniques [E05]
Gender: Female, Male. Age: 18-64 years, 65+ years. Enrolment: 15.
Status: Ongoing, recruiting. Start date (EU): 2022-04-18. Decision date: 2024-08-28. Results received: No. Last updated: 2024-08-28.

Condition(s): Breast cancer, neuroendocrine neoplasms, lymphomas, sarcomas
Product: Fluor-18-FDG, 400 MBq-210 GBq, injektionsvreske Fludeoxyglucose (18F), Hyperpolarized [1-13C]pyruvate

Primary endpoint: Quantification of tumor [1-13C]Pyruvate to [1-13C]Lactate conversion measured through dynamic conversion factors and signal ratios., Quantification of tumor uptake of 18-Flouro-deoxy-glucose measured as dynamic glucose influx (Ki) and static standardized uptake values (SUV).
Endpoint(s): Correlation between tumor 18-Flouro-deoxy-glucose uptakes and [1- 13C]Pyruvate to [1-13C]Lactate conversion and ex-vivo non-quantitative and quantitative expression of biomarkers involved in intracellular metabolism.

Source: https://euclinicaltrials.eu/ctis-public/view/2024-516131-28-00